EU clinical trial 2023-505641-12-00: A Phase 3 Randomized, Placebo-Controlled Trial With a Longitudinal Natural History Run-In and Open-Label Extension to Evaluate BIIB067 Initiated in Clinically Presymptomatic Adults With a Confirmed Superoxide Dismutase 1 Mutation (ATLAS)
Protocol code: 233AS303
Sponsor: Biogen Idec Research Limited (Pharmaceutical company). Phase: Therapeutic confirmatory (Phase III). Countries: Sweden (ended), Germany (ongoing, recruitment ended), Italy (ended), Spain (ongoing, recruitment ended), France (ended), Poland (ended).
Therapeutic area(s): Diseases [C] - Nervous System Diseases [C10]
Gender: Female, Male. Age: 18-64 years, 65+ years. Enrolment: 30.
Start date (EU): 2021-07-27. Decision date: 2024-08-08. Results received: No. Last updated: 2025-08-28.
Decision dates by country: FR: 2024-08-09, IT: 2024-08-13, ES: 2024-08-09, PL: 2024-08-29, DE: 2024-08-09, SE: 2024-08-08

Condition(s): Amyotrophic Lateral Sclerosis (ALS) associated with SOD1 gene mutation
Product: BIIB067, PL1, Solution for injection, Intrathecal use. [Placebo]

Primary endpoint: Parts B and C: Percentage of Participants with Emergence of Clinically Manifest ALS Within 24 Months of Part B Baseline. [Time Frame: Up to 24 months]
Endpoint(s): Parts B and C: Time to Emergence of Clinically Manifest ALS. [Time Frame: Up to 5.6 years]., Parts B and C: Change in ALS Functional Rating Scale (ALSFRS-R) Total Score. The ALSFRS-R measures 4 functional domains: respiratory, bulbar function, gross motor skills, and fine motor skills. There are 12 questions, each scored from 0 to 4, for a total possible score of 48, with higher scores representing better function. [Time Frame: Up to 5.6 years]., Parts B and C: Change from Baseline in Percent Predicted Slow Vital Capacity (SVC). [Time Frame: Up to 5.6 years]., Parts B and C: Percentage of Participants with Outcome as Death or Permanent Ventilation Based on time to Death or Permanent Ventilation Analysis. Permanent ventilation is defined as ≥22 hours of invasive or non-invasive mechanical ventilation per day for ≥21 consecutive days. [Time Frame: Up to 5.6 years]., Parts B and C: Percentage of Participants with Outcome as Deaths Based on Time to Death Analysis. [Time Frame: Up to 5.6 years]., Parts B, C and D: Number of Participants with Adverse Events (AEs) and Serious Adverse Events (SAEs) during the Treatment Period. [Time Frame: Parts B and C: Up to 5.6 years and Part D: Up to 2 years]., Parts B, C and D: Change from Baseline in Plasma NfL Concentrations. [Time Frame: Parts B and C: Up to 5.6 years and Part D: Up to 2 years]., Parts B, C and D: Change in Total Cerebrospinal Fluid (CSF) SOD1 Concentrations. [Time Frame: Parts B and C: Up to 5.6 years and Part D: Up to 2 years].

Source: https://euclinicaltrials.eu/ctis-public/view/2023-505641-12-00